EU clinical trial 2024-512585-34-00: A 3-Part, Randomized, Double-Blind, Placebo-Controlled Phase 2 Study to Evaluate Safety and Efficacy of Avapritinib (BLU 285), a Selective KIT Mutation-Targeted Tyrosine Kinase Inhibitor, in Indolent and Smoldering Systemic Mastocytosis with Symptoms Inadequately Controlled with Standard Therapy
Protocol code: BLU-285-2203
Sponsor: Blueprint Medicines Corp. (Pharmaceutical company). Phase: Therapeutic exploratory (Phase II). Countries: France (ongoing, recruitment ended), Netherlands (ongoing, recruitment ended), Denmark (ongoing, recruitment ended), Sweden (ongoing, recruitment ended), Germany (ongoing, recruitment ended), Italy (ongoing, recruitment ended), Spain (ongoing, recruitment ended), Belgium (ongoing, recruitment ended), Norway (ongoing, recruitment ended).
Therapeutic area(s): Diseases [C] - Hemic and Lymphatic Diseases [C15]
Gender: Female, Male. Age: 18-64 years, 65+ years. Enrolment: 114.
Status: Ongoing, recruitment ended. Start date (EU): 2019-02-27. Decision date: 2024-10-11. Results received: No. Last updated: 2026-07-07.
Decision dates by country: ES: 2024-10-11, FR: 2024-10-11, SE: 2024-10-14, NL: 2024-10-14, BE: 2024-10-14, DK: 2024-10-11, NO: 2024-10-15, DE: 2024-10-14, IT: 2024-10-30

Condition(s): Indolent Systemic Mastocytosis (ISM)
Product: Avapritinib Placebo Tablets, Avapritinib, Avapritinib

Primary endpoint: Part 1 •The RP2D in patients with ISM. Part 2 •Mean change in ISM-SAF TSS, from Baseline to C7D1. Part 3 •The long-term safety and efficacy of avapritinib.
Endpoint(s): • Change in measures of mast cell burden: serum tryptase, KIT D816V allele burden in blood, bone marrow mast cells. • Change in best supportive care usage. • Change in MC-QoL, PGIS, SF-12, PGIC, and EQ-5D-5L. • Safety and tolerability of avapritinib, as assessed by AEs, vital signs, electrocardiograms, and laboratory tests. • Pharmacokinetics of avapritinib (Part 1 and 2 only)

Source: https://euclinicaltrials.eu/ctis-public/view/2024-512585-34-00